EU clinical trial 2023-504411-32-00: C5041034 - A Phase 1, Open-Label, Randomized, Single Dose, Crossover Study to Estimate the Relative Bioavailability of Etrasimod (PF-07915503) Mini Tablets in Water and 3 Food Vehicles Compared to the Etrasimod (PF-07915503) Clinical IR Tablets Under Fasted Conditions, and to Evaluate Mini Tablet Palatability in Healthy Adult Participants
Protocol code: C5041034
Sponsor: Pfizer Inc. (Pharmaceutical company). Phase: Human Pharmacology (Phase I)- Other. Countries: Belgium (ended).
Therapeutic area(s): Diseases [C] - Immune System Diseases [C20]
Gender: Female, Male. Age: 18-64 years, 65+ years. Enrolment: 16.
Status: Ended. Start date (EU): 2023-08-23. End date (EU): 2024-01-04. End date: 2024-01-05. Decision date: 2023-06-12. Results received: Yes. Last updated: 2023-08-02.

Condition(s): immune-mediated inflammatory disorders, including ulcerative colitis, alopecia areata, atopic dermatitis, and eosinophilic esophagitis
Product: Etrasimod Arginine, Etrasimod Arginine Blue

Primary endpoint: Plasma AUClast, AUCinf and Cmax of etrasimod
Endpoint(s): Assessment of first dose HR reduction, TEAEs, clinical laboratory abnormalities, vital signs, PEs, and 12-lead ECGs, Assessment of palatability via questionnaire: mouth feel, bitterness, tongue/mouth burns, throat burn, and overall liking

Source: https://euclinicaltrials.eu/ctis-public/view/2023-504411-32-00